EU clinical trial 2023-503356-27-00: A randomized Phase 2 Study of ompenaclid versus placebo in combination with FOLFIRI plus bevacizumab in patients with previously treated RAS mutant advanced or metastatic colorectal cancer
Protocol code: RGX-202-002
Sponsor: Inspirna Inc. (Pharmaceutical company). Phase: Therapeutic exploratory (Phase II). Countries: Spain (ended), Belgium (ended), France (ended).
Therapeutic area(s): Diseases [C] - Neoplasms [C04]
Gender: Female, Male. Age: 18-64 years, 65+ years. Enrolment: 86.
Status: Ended. Start date (EU): 2023-09-07. End date (EU): 2025-04-02. Decision date: 2023-07-27. Results received: Yes. Last updated: 2024-07-03.
Decision dates by country: BE: 2023-07-28, FR: 2023-08-03, ES: 2023-07-27

Condition(s): Metastatic colorectal cancer that is resistant to the currently approved methods of treatment is recognized as a serious threat to public health worldwide. Research efforts in recent years have become increasingly geared towards discovering and developing new treatment regimens with modes of action distinct from those of established agents and with the ability to target subclasses of colorectal cancer, such as those associated with RAS mutations.
Product: FOLINIC ACID, FLUOROURACIL, BEVACIZUMAB, IRINOTECAN, Placebo to Match Ompenaclid 600 mg Tablets are intended for oral administration. The placebo tablets are yellow, modified oval and biconvex film-coated tablets that are approximately 9 mm in width and 18.8 mm in length. Composition of placebo tablets: Lactose Monohydrate (708mg), Microcrystalline Cellulose (263 mg), Croscarmellose Sodium (30 mg), Magnesium Stearate (vegetable grade) (10 mg), Opadry®03K12480 Yellow (30mg), purified water (q.c.). total weight: 1042 mg., ompenaclid

Primary endpoint: Overall response rate (ORR)
Endpoint(s): Progression-free survival (PFS) (key secondary objective): Overall survival (OS); Duration of response (DoR); Disease control rate (DCR), Adverse events, performance status (Eastern Cooperative Oncology Group [ECOG]), physical examinations, clinical laboratory values, vital signs, electrocardiogram, Steady state concentration, CKB levels identified in baseline tumor samples

Source: https://euclinicaltrials.eu/ctis-public/view/2023-503356-27-00